EU clinical trial 2024-519460-40-00: Randomized, double-blind, parallel group clinical trial to evaluate the efficacy and safety of PRGF eye drops as a treatment for dry eye disease in patients with glaucoma
Sponsor: Biotechnology Institute I Mas D S.L. (Pharmaceutical company). Phase: Phase III and phase IV (Integrated). Countries: Spain (ongoing, recruiting).
Therapeutic area(s): Diseases [C] - Eye Diseases [C11]
Gender: Female, Male. Age: 18-64 years, 65+ years. Enrolment: 70.
Status: Ongoing, recruiting. Start date (EU): 2022-11-08. Decision date: 2024-11-28. Results received: No. Last updated: 2024-11-28.

Condition(s): Glaucoma, Dry eye disease
Product: Plasma rich in growth factors

Primary endpoint: - Change in the degree of ocular staining at 6 months using the Oxford scale. - Evolution of symptomatology at 6 months according to the Ocular Surface Disease Index (OSDI).
Endpoint(s): - Change in the degree of ocular staining at 3 months using the Oxford scale., Change in symptomatology at 3 months according to the Ocular Surface Disease Index (OSDI)., Change in the amount of tears produced at 3 and 6 months using the Schirmer test., Change in tear breakup time (TBUT) at 3 and 6 months., - Evolution of conjunctival hyperemia at 3 and 6 months using the McMonnies photographic scale., - Evolution of corrected distance visual acuity in both eyes at 3 and 6 months., - Change in the concentration of inflammation biomarkers S100A8 and MMP-9 in tears at 3 and 6 months post-treatment., Demographic and identification variables - Patient code - Age - Sex - Toxic habits (alcohol, tobacco), Safety variables - Global tolerance assessed by the investigator at 3 and 6 months. - Patient-assessed global tolerance at 3 and 6 months. - Type and frequency of ocular adverse events. - Type and frequency of systemic adverse events.

Source: https://euclinicaltrials.eu/ctis-public/view/2024-519460-40-00